EU clinical trial 2025-522060-32-00: Randomised EValuation of Therapies for microvAscuLar Injury in STEACS – REVITALISE Study
Protocol code: 2503
Sponsor: Corflow Therapeutics AG (Industry). Phase: Therapeutic exploratory (Phase II). Countries: Netherlands (authorised, recruitment pending), Spain (authorised, recruitment pending), France (authorised, recruiting).
Therapeutic area(s): Diseases [C] - Cardiovascular Diseases [C14]
Gender: Female, Male. Age: 18-64 years, 65+ years. Enrolment: 210.
Start date (EU): 2026-07-26. Decision date: 2026-03-02. Results received: No. Last updated: 2026-07-08.
Decision dates by country: FR: 2026-03-06, ES: 2026-03-09, NL: 2026-03-02

Condition(s): STEMI (ST elevated Myocardial Infarction)
Product: Tirofiban Ibisqus 50 Mikrogramm/ml Infusionslösung, Adenosine 6 mg/2 ml solution for injection

Primary endpoint: The absolute change in left ventricular ejection fraction (LVEF), measured by transthoracic echocardiography (TTE), between 24 to 72 hours post-primary percutaneous coronary intervention (PPCI) and 6 months post-procedure. All assessments will be performed blinded to treatment group assignment.
Endpoint(s): Left ventricular regional wall motion score index (RWMSI) of the Infarct zone at 6 months, corrected for 24 to 72 hours post-PPCI RWMSI, assessed by 2D Transthoracic Echocardiography blinded to treatment group assignment., Primary safety endpoint formally tested for statistical significance is the Composite of device or procedure-related mortality, clinically driven target vessel/lesion revascularization, vessel dissection and IPTE (defined as the development of new or increasing thrombus, abrupt vessel closure, no reflow, slow reflow, and distal embolization at any point during the CoFI procedure) assessed at 30 days.

Source: https://euclinicaltrials.eu/ctis-public/view/2025-522060-32-00